EU clinical trial 2024-513440-29-00: A Phase 2 / Phase 3, Multicenter, Randomized, Multiple-Dose, Double-Blind, Placebo-Controlled Adaptive Study to Evaluate the Safety, Efficacy, and Pharmacokinetics of CSL889 in Adults and Adolescents with Sickle Cell Disease during Vaso-Occlusive Crisis
Protocol code: CSL889_2001
Sponsor: CSL Behring LLC (Pharmaceutical company). Phase: Phase II and Phase III (Integrated). Countries: Spain (ended), Italy (ended), Greece (ended), Netherlands (ended), Belgium (ended), Germany (ended), France (ended).
Therapeutic area(s): Diseases [C] - Hemic and Lymphatic Diseases [C15]
Gender: Female, Male. Age: 0-17 years, 18-64 years, 65+ years. Enrolment: 76.
Status: Ended. Start date (EU): 2025-06-25. End date (EU): 2025-12-02. Decision date: 2025-04-08. Results received: No. Last updated: 2025-11-19.
Decision dates by country: NL: 2025-04-14, FR: 2025-04-14, BE: 2025-04-08, DE: 2025-04-11, ES: 2025-04-09, GR: 2025-04-10, IT: 2025-04-11

Condition(s): Sickle cell disease vaso-occlusive crisis
Product: Hemopexin, Human, Placebo_ solution for infusion_ not active substance

Primary endpoint: Time to resolution of VOC (time to discontinuation of parenteral opioids), Number of participants with treatment-emergent adverse events (TEAEs), Percentage of participants with TEAEs, Number of participants with detectable treatment emergent (TE) anti-CSL889 antibodies, Percentage of participants with detectable TE anti-CSL889 antibodies
Endpoint(s): Hospital admission rate, Length of hospital stay (If hospitalized), Percentage of participants experiencing acute chest syndrome (ACS), acute kidney injury (AKI), or stroke, Length of acute care stay, Total Length of acute care and hospital stay, Re-presentation rate to an acute care facility for VOC or ACS after discharge, Hospital admission rate for VOC or ACS after discharge, Opioid consumption, Percentage of participants with >=30% pain reduction by NRS score, Maximum observed concentration (Cmax) after Doses 1 and 3 of CSL889, Area under the concentration (AUCtau) after Doses 1 and 3 of CSL889, Time of maximum concentration (Tmax) after Doses 1 and 3 of CSL889, Trough concentration (Ctrough) after each dose of CSL889, Accumulation ratio (AR) for AUCtau of CSL889 (the ratio between the AUCtau of Doses 3 and 1), AR for Cmax of CSL889 (the ratio between the Cmax of Doses 3 and 1), AR for Ctrough of CSL889 (the ratio between the Ctrough of the last dose and Dose 1), Ctrough after each dose in sparse PK subset of CSL889

Source: https://euclinicaltrials.eu/ctis-public/view/2024-513440-29-00